EU clinical trial 2025-524688-19-00: A Phase III Randomized, Double-blind, Placebo-controlled Multicenter Master Protocol to Evaluate the Efficacy and Safety of Elecoglipron in Participants with Obesity or Overweight with or without Type 2 Diabetes Mellitus (Embold)
Protocol code: D7260C00015
Sponsor: AstraZeneca AB (Pharmaceutical company). Phase: Therapeutic confirmatory (Phase III). Countries: Spain (authorised, recruitment pending), Germany (authorised, recruitment pending), Italy (authorised, recruitment pending), Poland (authorised, recruitment pending).
Therapeutic area(s): Diseases [C] - Nutritional and Metabolic Diseases [C18]
Gender: Female, Male. Age: 18-64 years, 65+ years. Enrolment: 1010.
Status: Authorised, recruitment pending. Decision date: 2026-07-27. Results received: No. Last updated: 2026-08-05.
Decision dates by country: DE: 2026-07-27, IT: 2026-07-29, ES: 2026-07-30, PL: 2026-07-29

Condition(s): Participants Living with Obesity or Overweight with at least 1 comorbidity with or without Type 2 Diabetes Mellitus
Product: Elecoglipron, Elecoglipron, Elecoglipron, Elecoglipron, Placebo for Elecoglipron (AZD5004)

Primary endpoint: Percent change from baseline to Week 72 in body weight
Endpoint(s): Absolute change from baseline to Week 72 in body weight, Achieved ≥ 5% body weight loss from baseline at Week 72, Achieved ≥ 10% body weight loss from baseline at Week 72, Achieved ≥ 15% body weight loss from baseline at Week 72, Percent change from baseline to Week 72 in body weight in participants with BMI ≥ 27 kg/m2 at baseline, Absolute change from baseline to Week 72 in waist circumference (cm), Change from baseline to Week 72 in hemoglobin A1c (HbA1c) (%), Achieved normoglycemia (HbA1c < 5.7% [39 mmol/mol]) at Week 72 in participants with HbA1c ≥ 5.7% (39 mmol/mol) at baseline Study 2 only: • Achieved HbA1c < 7.0% (53 mmol/mol) at Week 72 in participants with HbA1c ≥ 7.0% (53 mmol/mol) at baseline Study 2 only: • Achieved HbA1c ≤ 6.5% (48 mmol/mol) at Week 72 in participants with HbA1c ≥ 7.0% (53 mmol/mol) at baseline, Change from baseline to Week 72 in systolic blood pressure (mmHg)

Source: https://euclinicaltrials.eu/ctis-public/view/2025-524688-19-00